EU clinical trial 2025-520530-32-00: SPatial Heterogeneity of INtratumoral drug distribution
Protocol code: 29973113
Sponsor: Amsterdam UMC Stichting (Patient organisation/association). Phase: Therapeutic use (Phase IV). Countries: Netherlands (authorised, recruitment pending).
Therapeutic area(s): Diseases [C] - Neoplasms [C04]
Gender: Female. Age: 18-64 years, 65+ years. Enrolment: 40.
Status: Authorised, recruitment pending. Decision date: 2025-07-30. Results received: No. Last updated: 2026-04-16.

Condition(s): ER+ HER2- Breast cancer
Product: Letrozole 2.5 mg film coated tablets, Kisqali 200 mg film-coated tablets, Anastrozole 1 mg film-coated tablets.

Primary endpoint: Concentration of AI and CDK4/6 inhibitor (ribociclib) in different regions of the tumor tissue using mass spectrometry.
Endpoint(s): Characterization of both anatomical and functional spatial variations in the tumor microenvironment at the macroscopic level using magnetic resonance imaging (MRI) and Ultrasonography (US), Characterization of anatomical spatial variations in the tumor microenvironment at the microscopic scale using immunohistochemistry (IHC), Delineation of tumor habitats at macro- and microscopic level based on multimodality and multiparametric imaging, Immune subset frequencies and activation state in SLN and in peripheral blood by flow cytometry, at baseline and on treatment with AI +/- ribociclib, T cell functionality in SLN tested by cytokine release upon polyclonal stimulation, Cytokine/chemokine profiling performed on plasma samples, Immune effects of the treatment at the primary tumor site assessed by IHC, - (severe) adverse events due to ribociclib (according to criteria of common terminology for adverse events (CTCAE) 5.0 scored up to 30 days after surgery), Response to CDK4/6 inhibition + AI in primary tumor measured by - residual cancer burden (RCB) - Ki67 expression assessed by IHC

Source: https://euclinicaltrials.eu/ctis-public/view/2025-520530-32-00